EU clinical trial 2024-516520-34-00: Study of GS-0151 in Participants With Rheumatoid Arthritis
Protocol code: GS-US-667-6882
Sponsor: Gilead Sciences Inc. (Pharmaceutical company). Phase: Human Pharmacology (Phase I)- Other. Countries: Germany (ongoing, recruitment ended), Spain (ongoing, recruitment ended), Poland (ongoing, recruitment ended).
Therapeutic area(s): Diseases [C] - Musculoskeletal Diseases [C05]
Gender: Female, Male. Age: 18-64 years, 65+ years. Enrolment: 39.
Status: Ongoing, recruitment ended. Start date (EU): 2025-11-17. Decision date: 2025-08-20. Results received: No. Last updated: 2026-06-16.
Decision dates by country: PL: 2025-08-22, DE: 2025-08-20, ES: 2025-08-20

Condition(s): Rheumatoid Arthritis

Source: https://euclinicaltrials.eu/ctis-public/view/2024-516520-34-00